EU clinical trial 2024-515795-12-00: A study in healthy people to test whether erythromycin influences the amount of BI 1291583 in the blood.
Protocol code: 1397-0029
Sponsor: Boehringer Ingelheim International GmbH (Pharmaceutical company). Phase: Human Pharmacology (Phase I)- Other. Countries: Germany (ended).
Therapeutic area(s): Not possible to specify
Gender: Female, Male. Age: 18-64 years. Enrolment: 16.
Status: Ended. Start date (EU): 2025-04-29. End date (EU): 2025-09-09. Decision date: 2025-03-20. Results received: No. Last updated: 2025-04-29.

Condition(s): Healthy volunteer trial

Source: https://euclinicaltrials.eu/ctis-public/view/2024-515795-12-00